EU clinical trial 2024-517924-20-00: PIGMENT – PDE6A gene therapy for retinitis pigmentosa
Protocol code: RDC-PDE6A-01
Sponsor: Universitaetsklinikum Tuebingen AöR (Hospital/Clinic/Other health care facility). Phase: Phase I and Phase II (Integrated)- First administration to humans. Countries: Germany (ongoing, recruitment ended).
Therapeutic area(s): Diseases [C] - Eye Diseases [C11]
Gender: Female, Male. Age: 18-64 years, 65+ years. Enrolment: 9.
Status: Ongoing, recruitment ended. Start date (EU): 2019-09-24. Decision date: 2024-09-24. Results received: No. Last updated: 2025-07-17.

Condition(s): PDE6A-linked Retinitis Pigmentosa

Source: https://euclinicaltrials.eu/ctis-public/view/2024-517924-20-00